EU clinical trial 2024-517352-35-00: Durability of Immunity induced by the Ebolavirus Vaccine VSV-EBOV and Assessment of a Booster Dose for Pre-Exposure Prophylaxis in Individuals at Potential Occupational Risk for Ebolavirus Exposure: a German Multicenter Study (PREPARE-Germany)
Protocol code: Prepare-Germany
Sponsor: University Medical Center Hamburg-Eppendorf (Hospital/Clinic/Other health care facility). Phase: Phase II and Phase III (Integrated). Countries: Germany (ended).
Therapeutic area(s): Diseases [C] - Virus Diseases [C02]
Gender: Female, Male. Age: 18-64 years. Enrolment: 70.
Status: Ended. End date (EU): 2026-06-18. Decision date: 2024-10-18. Results received: No. Last updated: 2024-10-18.

Condition(s): Ebola virus infection
Product: Ervebo solution for injection Ebola Zaire Vaccine (rVSV∆G-ZEBOV-GP, live)

Primary endpoint: 1. Binding anti-EBOV antibody titers I. The course of anti-EBOV immunoglobulin as measured by EBOV ELISA titers during the 24 months following primary vaccination II. Anti-EBOV immunoglobulin as measured by EBOV ELISA titers at 12 and 24 months follow-up, 2. Anti-EBOV neutralizing antibody titers I. The course of anti-EBOV neutralizing antibody titers during the 24 months following primary vaccination II. Anti-EBOV neutralizing titers at 12 and 24 months follow-up
Endpoint(s): Occurrence of Grade ≥ 3 AE until one month after primary and booster vaccination, Occurrence of SAE throughout the study

Source: https://euclinicaltrials.eu/ctis-public/view/2024-517352-35-00